EU clinical trial 2025-522920-28-00: Understanding the effect of CagriSema, cagrilintide, and semaglutide on muscle health
Protocol code: NN9838-8411
Sponsor: Novo Nordisk A/S (Pharmaceutical company). Phase: Human Pharmacology (Phase I)- Other. Countries: Denmark (ongoing, recruiting).
Therapeutic area(s): Diseases [C] - Nutritional and Metabolic Diseases [C18]
Gender: Female, Male. Age: 18-64 years, 65+ years. Enrolment: 100.
Status: Ongoing, recruiting. Start date (EU): 2026-04-10. Decision date: 2026-03-06. Results received: No. Last updated: 2026-03-06.

Condition(s): Obesity, CCI, CCI

Source: https://euclinicaltrials.eu/ctis-public/view/2025-522920-28-00